EU clinical trial 2024-515164-30-00: CALCIGRAN FORTE AND DOSING OF IMMUNOSUPPRESSIVE DRUGS IN KIDNEY TRANSPLANT RECIPIENTS
Protocol code: CalciTx
Sponsor: Oslo University Hospital HF (Hospital/Clinic/Other health care facility). Phase: Therapeutic use (Phase IV). Countries: Norway (ended).
Therapeutic area(s): Analytical, Diagnostic and Therapeutic Techniques and Equipment [E] - Therapeutics [E02]
Gender: Female, Male. Age: 18-64 years, 65+ years. Enrolment: 26.
Status: Ended. Start date (EU): 2024-09-25. End date (EU): 2025-12-04. Decision date: 2024-09-25. Results received: No. Last updated: 2024-09-25.

Condition(s): Kidney transplantation
Product: CellCept 500 mg film-coated tablets, PROGRAF 1 mg capsule, Calcigran Forte 500 mg/400 IE tyggetabletter, Prednisolone 5 mg Tablets

Primary endpoint: AUC0-12 and Cmax of tacrolimus/mycophenolate with:without (calcium supplement coadministration) ratio (according to EMA bioequivalence guidelines)
Endpoint(s): Tacrolimus pharmacokinetic parameters and variables such as AUC0-12, Cmax, Fabs, C0, C12, CL, popPK model parameters, Mycophenolate mofetil pharmacokinetic parameters and variables such as AUC0-12, Cmax, Fabs, C0, C12, CL, popPK model parameters, Prednisolone pharmacokinetic parameters and variables such as AUC0-12, Cmax, Fabs, C0, C12, CL, popPK model parameters, Metagenomic feces analyses, feces derived ex vivo drug conversion rates

Source: https://euclinicaltrials.eu/ctis-public/view/2024-515164-30-00